EU clinical trial 2024-511506-22-00: A two-centre open-label non-inferiority trial to assess the immunogenicity and safety of an intradermal and an intramuscular single-visit dosing regimen of purified chick-embryo cell-culture rabies vaccine in adults
Sponsor: Institute Of Tropical Medicine (Hospital/Clinic/Other health care facility). Phase: Therapeutic confirmatory (Phase III). Countries: Belgium (ended).
Therapeutic area(s): Diseases [C] - Virus Diseases [C02]
Gender: Female, Male. Age: 18-64 years. Enrolment: 360.
Status: Ended. Start date (EU): 2023-01-11. End date (EU): 2025-08-28. Decision date: 2024-04-05. Results received: No. Last updated: 2024-07-29.

Condition(s): Rabies
Product: Rabipur Pulver und Lösungsmittel zur Herstellung einer Injektionslösung in Fertigspritze Tollwutvirus (inaktiviert, Stamm Flury LEP)

Primary endpoint: Difference in boostability on day 7 after the booster between the respective intervention groups and the standard of care group.
Endpoint(s): Percentage of subjects that have rabies antibodies ≥3.0 IU/ml on day 7 and day 28 after booster vaccination in all groups., Percentage of subjects that have rabies antibodies ≥10.0 IU/ml on day 7 and day 28 after booster vaccination in all groups., Percentage of subjects that have rabies antibodies ≥ 0.5 IU/ml on day 28 after pre-exposure vaccination in all groups, Percentage of subjects that have rabies antibodies ≥ 0.5 IU/ml at every visit for each regimen., Rabies serology slopes between the successive visits after the booster in all groups, Mean difference in antibody response between day of the booster and day 7, day 28, and day 90 after the booster., GMTs at all visits in all arms and the ratio between the GMTs in the intervention arms respectively and the standard of care arm.

Source: https://euclinicaltrials.eu/ctis-public/view/2024-511506-22-00